EU clinical trial 2023-509273-24-00: Efficacy and safety of cagrilintide s.c. in combination with semaglutide s.c. (CagriSema s.c. 1.0 mg/1.0 mg and 1.7 mg/1.7 mg) once-weekly in participants with overweight or obesity
Protocol code: NN9838-7749
Sponsor: Novo Nordisk A/S (Pharmaceutical company). Phase: Therapeutic confirmatory (Phase III). Countries: France (ended), Germany (ended).
Therapeutic area(s): Diseases [C] - Nutritional and Metabolic Diseases [C18]
Gender: Female, Male. Age: 18-64 years, 65+ years. Enrolment: 100.
Status: Ended. Start date (EU): 2024-09-05. End date (EU): 2026-04-22. End date: 2026-04-23. Decision date: 2024-06-26. Results received: No. Last updated: 2026-03-04.
Decision dates by country: DE: 2024-06-26, FR: 2024-06-28

Condition(s): Obesity
Product: cagrilintide semaglutide, Placebo + Placebo, cagrilintide semaglutide, cagrilintide semaglutide, cagrilintide semaglutide

Primary endpoint: Relative change in body weight, Achievement of ≥5% weight reduction
Endpoint(s): Achievement of ≥10 % weight reduction, Achievement of ≥15% weight reduction, Achievement of ≥20% weight reduction, Change in waist circumference, Change in systolic blood pressure, Ratio to baselin in lipids: Total cholesterol, HDL cholesterol, LDL cholesterol, VLDL cholesterol, Triglycerids, Free fatty acids

Source: https://euclinicaltrials.eu/ctis-public/view/2023-509273-24-00